EU clinical trial 2024-510809-28-00: C3441052 - TALAPRO-3: A Phase 3, Randomized, Double-Blind Study of Talazoparib with Enzalutamide Versus Placebo with Enzalutamide in Men with DDR Gene Mutated Metastatic Castration-Sensitive Prostate Cancer
Protocol code: C3441052
Sponsor: Pfizer Inc. (Pharmaceutical company). Phase: Therapeutic confirmatory (Phase III). Countries: Czechia (ongoing, recruitment ended), Slovakia (ongoing, recruitment ended), Belgium (ongoing, recruitment ended), Italy (ongoing, recruitment ended), Finland (ongoing, recruitment ended), Germany (ongoing, recruitment ended), Norway (ongoing, recruitment ended), Bulgaria (ongoing, recruitment ended), France (ongoing, recruitment ended), Netherlands (ongoing, recruitment ended), Hungary (ongoing, recruitment ended), Spain (ongoing, recruitment ended).
Therapeutic area(s): Diseases [C] - Neoplasms [C04]
Gender: Male. Age: 18-64 years, 65+ years. Enrolment: 207.
Status: Ongoing, recruitment ended. Start date (EU): 2021-09-27. Decision date: 2024-06-10. Results received: No. Last updated: 2026-08-07.
Decision dates by country: HU: 2024-06-10, SK: 2024-06-10, FI: 2024-06-10, IT: 2024-06-17, NL: 2024-06-10, BE: 2024-06-10, ES: 2024-06-17, NO: 2024-06-12, FR: 2024-06-11, BG: 2024-06-10, CZ: 2024-06-11, DE: 2024-06-13

Condition(s): Metastatic Castration-sensitive Prostate Cancer
Product: Talazoparib placebo, Xtandi - 40 mg soft capsules, Xtandi 40 mg soft capsules, TALAZOPARIB, Xtandi - 40 mg soft capsules, TALAZOPARIB, Xtandi - 40 mg soft capsules

Primary endpoint: Investigator-assessed rPFS per Response Evaluation Criteria in Solid Tumors (RECIST 1.1 [soft tissue disease]) and Prostate Cancer Working Group (PCWG3 [bone disease]) in participants with mCSPC harboring HRR deficiencies.
Endpoint(s): OS in participants with mCSPC harboring HRR deficiencies (alpha protected).

Source: https://euclinicaltrials.eu/ctis-public/view/2024-510809-28-00